EU clinical trial 2025-524728-22-01: ACTIVATE - Phase 1 Clinical Trial evaluating the combination of Actinomycin D and venetoclax in patients with Relapsed/Refractory (R/R) Acute Myeloid Leukemia (AML)
Protocol code: APHP251246
Sponsor: Assistance Publique Hopitaux De Paris (Hospital/Clinic/Other health care facility). Phase: Phase I and Phase II (Integrated)- Other. Countries: France (authorised, recruitment pending).
Therapeutic area(s): Not possible to specify; Diseases [C] - Hemic and Lymphatic Diseases [C15]; Diseases [C] - Neoplasms [C04]
Gender: Female, Male. Age: 18-64 years, 65+ years. Enrolment: 36.
Status: Authorised, recruitment pending. Decision date: 2026-06-10. Results received: No. Last updated: 2026-06-10.

Condition(s): Relapsed/Refractory (R/R) Acute Myeloid Leukemia (AML)

Source: https://euclinicaltrials.eu/ctis-public/view/2025-524728-22-01